EU clinical trial 2022-502402-32-00: Cluster randomised trial of low molecular weight heparins - Directly through Epic
Sponsor: Rigshospitalet (Hospital/Clinic/Other health care facility). Phase: Therapeutic use (Phase IV). Countries: Denmark (ended).
Therapeutic area(s): Diseases [C] - Cardiovascular Diseases [C14]
Gender: Female, Male. Age: 18-64 years, 65+ years. Enrolment: 65000.
Status: Ended. End date (EU): 2025-03-25. Decision date: 2023-01-18. Results received: No. Last updated: 2024-05-31.

Condition(s): Venous thromboembolism
Product: TINZAPARIN, DALTEPARIN

Primary endpoint: Major bleeding requiring blood transfusion and all-cause mortality at 30 days
Endpoint(s): 1. All-cause 30 day mortality 2. All-cause 365 day mortality 3. Blood transfusion during admission 4. Pulmonary embolism at 30 days 5. Heparin induced thrombocytopenia 6. Liver failure 7. Length of hospital admission 8. Days alive out of hospital

Source: https://euclinicaltrials.eu/ctis-public/view/2022-502402-32-00